EU clinical trial 2023-507024-24-00: A Phase 3, Randomized, Double-blind Trial of Pembrolizumab (MK-3475) Plus Enzalutamide Plus ADT Versus Placebo Plus Enzalutamide Plus ADT in Participants With Metastatic Hormone-Sensitive Prostate Cancer (mHSPC) (KEYNOTE-991)
Protocol code: MK-3475-991
Sponsor: Merck Sharp & Dohme LLC (Pharmaceutical company). Phase: Therapeutic confirmatory (Phase III). Countries: Denmark (ended), Poland (ended), Ireland (ended).
Therapeutic area(s): Diseases [C] - Neoplasms [C04]
Gender: Male. Age: 18-64 years, 65+ years. Enrolment: 122.
Status: Ended. Start date (EU): 2020-05-05. End date (EU): 2026-01-22. End date: 2026-04-08. Decision date: 2024-01-05. Results received: No. Last updated: 2026-01-26.
Decision dates by country: IE: 2024-01-08, DK: 2024-01-05, PL: 2024-01-10

Condition(s): Metastatic hormone sensitive prostate cancer
Product: Placebo for pembrolizumab, ENZALUTAMIDE, PEMBROLIZUMAB

Primary endpoint: Radiographic Progression-free Survival (rPFS) Per Prostate Cancer Working Group (PCWG)-modified Response Evaluation Criteria in Solid Tumors Version 1.1 (RECIST 1.1) as Assessed by Blinded Independent Central Review, Overall Survival (OS)
Endpoint(s): Time to Initiation of the First Subsequent Anti-cancer Therapy or Death (TFST), Time to Symptomatic Skeletal-Related Event (TTSSRE), Time to Prostate-specific Antigen (PSA) Progression, Time to Radiographic Soft Tissue Progression Per Soft Tissue Rules of Prostate Cancer Working Group (PCWG)-modified Response Evaluation Criteria in Solid Tumors Version 1.1 (RECIST 1.1) as Assessed by Blinded Independent Central Review, Time to Pain Progression (TTPP) as Assessed by Brief Pain Inventory-Short Form (BPI-SF) Item 3 ("Worst Pain in 24 Hours") and Opiate Use, Time from Randomization to Disease Progression as Determined by Investigator Assessment after Next-line of Therapy or Death from Any Cause, Whichever Occurs First (PFS2), Prostate-specific Antigen (PSA) Response Rate, Prostate-specific antigen (PSA) Undetectable Rate, Objective Response Rate (ORR) Per Prostate Cancer Working Group (PCWG)-modified Response Evaluation Criteria in Solid Tumors Version 1.1 (RECIST 1.1) as Assessed by Blinded Independent Central Review, Duration of Response (DOR) Per Prostate Cancer Working Group (PCWG)-modified Response Evaluation Criteria in Solid Tumors Version 1.1 (RECIST 1.1) as Assessed by Blinded Independent Central Review, Number of Participants Who Experience an Adverse Event (AE), Number of Participants Who Discontinue Study Treatment Due to an Adverse Event (AE)

Source: https://euclinicaltrials.eu/ctis-public/view/2023-507024-24-00